EU clinical trial 2024-520212-18-00: A single-dose, open-label, randomized, two-period, two-sequence, crossover pivotal bioequivalence study on Dapagliflozin 10 mg film-coated tablets (Polfa Tarchomin S.A., Poland) versus Froxiga 10 mg film-coated tablets (AstraZeneca AB, Sweden) in healthy volunteers under fasting conditions.
Protocol code: 01-DAP-BIO-24
Sponsor: Tarchominskie Zaklady Farmaceutyczne Polfa S.A. (Pharmaceutical company). Phase: Human Pharmacology (Phase I)- Bioequivalence Study. Countries: Czechia (ended).
Therapeutic area(s): Diseases [C] - Hormonal diseases [C19]
Gender: Female, Male. Age: 18-64 years. Enrolment: 36.
Status: Ended. Start date (EU): 2025-04-03. End date (EU): 2025-06-04. Decision date: 2025-03-27. Results received: No. Last updated: 2025-03-27.

Condition(s): intended for treatment of for the treatment of (2): • insufficiently controlled type 2 diabetes mellitus as an adjunct to diet and exercise. • symptomatic chronic heart failure. • chronic kidney disease.

Source: https://euclinicaltrials.eu/ctis-public/view/2024-520212-18-00